EU clinical trial 2024-511260-84-00: A Two-part, Multicenter, Randomized, Double-blind, Placebo-controlled Study to Evaluate the Safety and Efficacy of APG777 in Patients with Moderate-to-severe Atopic Dermatitis
Protocol code: APG777-201
Sponsor: Apogee Therapeutics Inc. (Pharmaceutical company). Phase: Therapeutic exploratory (Phase II). Countries: Poland (ongoing, recruitment ended), Czechia (ongoing, recruitment ended), France (ongoing, recruitment ended), Germany (ongoing, recruitment ended), Hungary (ongoing, recruitment ended), Spain (ongoing, recruitment ended).
Therapeutic area(s): Diseases [C] - Skin and Connective Tissue Diseases [C17]
Gender: Female, Male. Age: 18-64 years, 65+ years. Enrolment: 163.
Status: Ongoing, recruitment ended. Start date (EU): 2024-09-03. Decision date: 2024-08-12. Results received: No. Last updated: 2026-02-12.
Decision dates by country: HU: 2024-10-21, DE: 2024-10-07, PL: 2024-08-12, FR: 2024-10-23, CZ: 2024-11-12, ES: 2024-10-04

Condition(s): Atopic Dermatitis
Product: Placebo, APG777

Primary endpoint: Part A: Percent Change from Baseline in Eczema Area and Severity Index (EASI) [Time Frame: Baseline and at Week 16] Part B: Proportion of patients who achieve EASI 75 at Week 16
Endpoint(s): Part A and B: Number of Participants with Treatment Emergent Adverse Events (TEAEs) [Time Frame: Up to 106 Weeks], Change from Baseline in EASI [Time Frame: Baseline, through Week 16 and at Week 52], Percent Change from Baseline in EASI [Time Frame: Baseline through Week 16 and at Week 52], Proportion of Participants Achieving EASI 50, 75, 90, and 100 Score [Time Frame: Baseline through Week 16 and at Week 52], Proportion of Participants Achieving a Validated Investigator Global Assessment (vIGA-AD) Score of 0 (clear) or 1 (almost clear) and a >=2-Point Reduction [Time Frame: Baseline through Week 16 and at Week 52], Change from Baseline in BSA Involvement [Time Frame: Baseline through Week 16 and at Week 52], Proportion of Participants Achieving a >=4 Point Improvement in the Weekly Mean of the Daily Itch Numeric Rating Scale (I-NRS) [Time Frame: Baseline through Week 16 and at Week 52], Percent Change from Baseline in the Weekly Mean of the Daily I-NRS [Time Frame: Baseline through Week 16 and at Week 52], Serum Concentrations of APG777 Over Time [Time Frame: Up to 106 Weeks], Predose Serum Concentrations of APG777 (Ctrough) [Time Frame: Up to 106 Weeks], Maximum concentration (Cmax) of APG777 [Time Frame: Up to 106 Weeks], Time to reach Cmax (tmax) [Time Frame: Up to 106 Weeks], Area Under the Concentration-Time Curve (AUC) from Time 0 to Time t (AUC0-t) in the Induction Period [Time Frame: Baseline to 16 Weeks], AUC Over the Dosing Interval (AUC0-tau) in the Maintenance Period [Time Frame: 16 Weeks to 52 Weeks]

Source: https://euclinicaltrials.eu/ctis-public/view/2024-511260-84-00